EU clinical trial 2023-506908-66-00: Usefulness of Corifollitropin alfa as alternative to conventional daily rFSH protocols in oocyte donors undergoing pituitary suppression with Medroxiprogesterona acetate (MPA).
Protocol code: 2304-VLC-051-JG
Sponsor: Ivi Valencia S.L. (Hospital/Clinic/Other health care facility). Phase: Therapeutic confirmatory (Phase III). Countries: Spain (ongoing, recruiting).
Therapeutic area(s): Diseases [C] - Female Urogenital Diseases and Pregnancy Complications [C13]
Gender: Female. Age: 18-64 years. Enrolment: 130.
Status: Ongoing, recruiting. Start date (EU): 2025-06-17. Decision date: 2023-12-13. Results received: No. Last updated: 2026-06-16.

Condition(s): Female infertility
Product: CORIFOLLITROPIN ALFA, FOLLITROPIN BETA

Primary endpoint: Number of MII oocytes and mature oocyte rate

Source: https://euclinicaltrials.eu/ctis-public/view/2023-506908-66-00